EU clinical trial 2022-501317-31-00: Phase 1 Study of BMS-986416 with and without Nivolumab in Solid Tumors
Protocol code: CA102-003
Sponsor: Bristol-Myers Squibb International Corporation (Pharmaceutical company). Phase: Human Pharmacology (Phase I)- Bioequivalence Study. Countries: Belgium (ended), Netherlands (ended).
Therapeutic area(s): Diseases [C] - Neoplasms [C04]
Gender: Female, Male. Age: 18-64 years, 65+ years. Enrolment: 7.
Status: Ended. Start date (EU): 2023-06-29. End date (EU): 2024-05-31. End date: 2025-02-27. Decision date: 2023-06-13. Results received: No. Last updated: 2024-05-02.
Decision dates by country: BE: 2023-06-13, NL: 2023-06-19

Condition(s): Solid tumor

Source: https://euclinicaltrials.eu/ctis-public/view/2022-501317-31-00